EU clinical trial 2024-513501-31-00: An Open Label Study to Determine the Long Term Safety, Tolerability and Biological Activity of SAR422459 in Patients with Stargardt’s Macular Degeneration
Protocol code: LTS13588
Sponsor: Sanofi-Aventis Recherche & Developpement (Pharmaceutical company). Phase: Therapeutic exploratory (Phase II). Countries: France (ongoing, recruitment ended).
Therapeutic area(s): Diseases [C] - Eye Diseases [C11]
Gender: Female, Male. Age: 0-17 years, 18-64 years. Enrolment: 14.
Status: Ongoing, recruitment ended. Start date (EU): 2013-05-30. Decision date: 2024-08-13. Results received: No. Last updated: 2026-04-01.

Condition(s): Congenital, hereditary and neonatal diseases
Product: SAR422459

Primary endpoint: The incidence of Adverse Events
Endpoint(s): Clinically important changes in ocular safety assessments, Delay in retinal degeneration

Source: https://euclinicaltrials.eu/ctis-public/view/2024-513501-31-00